EU clinical trial 2024-519966-31-00: Phase I/IIa clinical trial with dose escalation to evaluate safety and efficacy of the infusion of CART84 in relapsed/refractory (R/R) acute myeloid leukemia (AML) and acute lymphoblastic T leukemia patients (T-ALL).
Protocol code: GYA-CART84-AL-001
Sponsor: Gyala Therapeutics S.L. (Pharmaceutical company). Phase: Phase I and Phase II (Integrated)- First administration to humans. Countries: Spain (ongoing, recruiting).
Therapeutic area(s): Diseases [C] - Hemic and Lymphatic Diseases [C15]; Diseases [C] - Neoplasms [C04]
Gender: Female, Male. Age: 18-64 years, 65+ years. Enrolment: 39.
Status: Ongoing, recruiting. Start date (EU): 2025-09-08. Decision date: 2025-08-12. Results received: No. Last updated: 2026-06-03.

Condition(s): Relapsed/refractory Acute Lymphoblastic T Leukemia (T-ALL), Relapsed/Refractory Acute Myeloid Leukemia
Product: GYA01

Primary endpoint: Phase I: Frequency and severity of AEs and SAEs occurring after CART84 infusion using the CTCAE V 5.0 and ASTCT grading for CRS/ICANS. The following AEs will be considered AESI: Infusion reactions, tumor lysis syndrome (TLS), CRS, ICANS,, immune effector cell associated hemophagocytic lymphohistiocytosis-like syndrome (IEC-HS), prolonged cytopenia grade >3 (beyond 6 months), hepatitis B reactivation, infections meeting SAE criteria, and second neoplasms., Phase IIa: Proportion of patients achieving ORR at day 30 after first infusion of CART84 as assessed by European Leukemia Net (ELN) 2022 guidelines.
Endpoint(s): Phase I: Proportion of patients achieving ORR at day 30 after first infusion of CART84 as assessed by European Leukemia Net (ELN) 2022 guidelines, Phase I: Proportion of patients achieving late ORR, defined as a response occurring after day 30 and up to day 90, provided that no other therapy has been administered (additional CART84 cell infusions beyond day 30 are allowed in specific situations, as per protocol)., Phase I: Proportion of patients achieving measurable residual disease (MRD)-negative remission in bone marrow (BM) by polymerase chain reaction (PCR) and/or flow cytometry at day 30, Phase I: Proportion of CART84-infused patients undergoing allo-HSCT (and achieving hematopoietic donor engraftment)., Phase I: Proportion of patients with detectable CART84 cells by PCR in peripheral blood and/or bone marrow (BM) at day 30 and day 90 following CART84 infusion, comparing those who proceed to allo-HSCT versus those who do not at the last follow-up., Phase I: Proportion of enrolled patients for whom a CART84 product can be manufactured and administered as per protocol., Phase IIa: Proportion of patients achieving late ORR, defined as occurring after day 30 and until day 90, given that no additional therapy outside the protocol has been received, Phase IIa: Proportion of patients achieving MRD-negative remission, CR, duration of response (DoR) according to allo-HSCT (at day 30, 6, 12 and 24 months following CART84 infusion), relapse-free survival (RFS), event-free survival (EFS), overall survival (OS)., Phase IIa: Incidence of CD84-negative relapse., Phase IIa: Frequency and severity of AEs and SAEs. The following AEs will be considered of special interest (AESI): Infusion reactions, tumor lysis syndrome (TLS), CRS, ICANS,, immune effector cell-associated hemophagocytic lymphohistiocytosis-like syndrome (IEC-HS), prolonged cytopenia grade >3 (beyond 6 months), hepatitis B reactivation, infections meeting SAE criteria, and second neoplasms, Phase IIa: Detection of CART cells measured by PCR in the peripheral blood and BM following CART84 infusion., Phase IIa: Hematologic recovery, based on serial peripheral blood counts after CART84 infusion., Phase IIa: Percentage of CART84-infused patients undergoing allo-HSCT (and achieving hematopoietic donor engraftment)., Phase IIa: Description of allo-HSCT procedures (donor type, conditioning, stem-cell source, GvHD prophylaxis) and related complications: graft failure, incidence and grading of acute and chronic GvHD, infection, other organ-related toxicities such as SOS, cardiotoxicity, or non-relapse mortality (NRM) with all associated causes., Phase IIa: Proportion of enrolled patients for whom a CART84 product can be manufactured and administered as per protocol.

Source: https://euclinicaltrials.eu/ctis-public/view/2024-519966-31-00